EU clinical trial 2022-502998-42-00: Vericiguat in Vasospastic Angina (ViVA)
Sponsor: Amsterdam UMC (Hospital/Clinic/Other health care facility). Phase: Therapeutic exploratory (Phase II). Countries: Netherlands (ended).
Therapeutic area(s): Diseases [C] - Cardiovascular Diseases [C14]; Analytical, Diagnostic and Therapeutic Techniques and Equipment [E] - Therapeutics [E02]
Gender: Female, Male. Age: 18-64 years, 65+ years. Enrolment: 55.
Status: Ended. Start date (EU): 2025-02-10. End date (EU): 2026-07-13. Decision date: 2023-06-30. Results received: No. Last updated: 2026-01-21.

Condition(s): Unequivocal epicardial and/or microvascular vasospastic angina
Product: Verquvo 10 mg film-coated tablets, Verquvo 2.5 mg film-coated tablets, MIOCHOL-E, NIPRUSS 60 mg, poeder voor oplossing voor infusie, NovoRapid 100 units/ml solution for injection in vial, Placebo 5 mg (BAY 1021189 PLAC TABL 305 COAT, 306 COAT), Placebo 2.5 mg (BAY 1021189 PLAC TABL 305 COAT, 306 COAT), Placebo 10 mg (BAY 1021189 PLAC TABL 305 COAT, 306 COAT), Verquvo 5 mg film-coated tablets, Miovisin 20mg/2ml polvere e solvente per soluzione iniettabile per uso intraoculare.

Primary endpoint: Difference in area under the curve for cutaneous microvascular conductance in APU/s during acetylcholine iontophoresis after 10-week placebo- versus 10-week vericiguat treatment periods, Difference in daily episodes of angina recorded on the ORBITA-app after placebo- versus 10-week vericiguat treatment periods.
Endpoint(s): Difference in peak cutaneous microvascular conductance in APU/mmHg during acetylcholine iontophoresis after 10-week placebo- versus 10-week vericiguat treatment periods, Difference in the absolute and relative change in cutaneous microvascular conductance from baseline conditions to peak conductance during acetylcholine iontophoresis in APU/mmHg) after 10-week placebo- versus 10-week vericiguat treatment, Difference in vasodilator function assessed with EndoPAT after 10-week placebo versus 10-week vericiguat treatment expressed by the Reactive hyperemia index (RHI), calculated as the index of signal amplitude pre-to-post occlusion in the occluded arm, divided by the same ratio in the control arm, Microvascular function assessed with LASCA on placebo versus vericiguat treatment using SNP and insulin: Difference in cutaneous microvascular conductance in APU/mmHg during SNP or insulin iontophoresis after 10-week placebo- versus 10-week vericiguat treatment periods, Microvascular function assessed with LASCA on placebo versus vericiguat treatment using SNP and insulin: Difference in the area under the curve for cutaneous microvascular conductance in APU/s during SNP or insulin iontophoresis after 10-week placebo- versus 10-week vericiguat treatment periods, Difference in peak cutaneous microvascular conductance, area under the curve for cutaneous microvascular conductance, absolute and relative changes in cutaneous microvascular conductance, and reactive hyperemia index after 10-week placebo versus 10-week vericiguat treatment stratified by the vericiguat dose reached during the treatment phase (5 or 10mg), Peak cutaneous microvascular conductance, area under the curve for cutaneous microvascular conductance, absolute and relative changes in cutaneous microvascular conductance, and reactive hyperemia index after 10-week placebo versus 10-week vericiguat treatment stratified by epicardial or microvascular vasospasm endotype., Difference in quality of life measured by the ORBITA-2 application, Seattle Angina Questionnaire Summary Score, Rose Dyspnea Score, EQ-5D-5L and EQ-VAS scores, iPCQ and iMCQ index scores after 10-week placebo versus 10-week vericiguat treatment periods, Difference in the change in quality of life measured by the ORBITA-2 application, Seattle Angina Questionnaire Summary Score, Rose Dyspnea Score, EQ-5D-5L and EQ-VAS scores, iPCQ and iMCQ index scores from baseline (prior to randomization) to 10-week placebo and 10-week vericiguat treatment periods, Angina burden calculated by the frequency of angina attacks for placebo versus vericiguat treatment periods, using the ORBITA-2 application., The occurrence of major adverse cardiac events (hospitalization for angina, spontaneous myocardial infarction, unplanned revascularization, death) during the study period.

Source: https://euclinicaltrials.eu/ctis-public/view/2022-502998-42-00